EU clinical trial 2023-503892-83-00: First-in-human study to assess the safety, tolerability, pharmacokinetics, and pharmacodynamics of VTX-PID in healthy male volunteers
Protocol code: VTX-PID_CLN_001
Sponsor: Vivet Therapeutics (Pharmaceutical company). Phase: Human Pharmacology (Phase I)- First administration to humans. Countries: Germany (ended).
Therapeutic area(s): Phenomena and Processes [G] - Immune system processes [G12]
Gender: Male. Age: 18-64 years. Enrolment: 35.
Status: Ended. Start date (EU): 2024-12-27. End date (EU): 2025-06-28. Decision date: 2023-09-28. Results received: No. Last updated: 2025-06-04.

Condition(s): Healthy volunteers with circulating Neutralising antibodies (NAbs) against AAV

Source: https://euclinicaltrials.eu/ctis-public/view/2023-503892-83-00